EU clinical trial 2024-514084-26-00: A Global Multicenter, Open Label, Randomized Phase III Confirmatory Study of Lisaftoclax (APG-2575) in Combination with Acalabrutinib versus Immunochemotherapy in Patients with Newly Diagnosed Chronic Lymphocytic Leukemia/Small Lymphocytic Lymphoma (GLORA-2 Study)
Protocol code: APG2575CC301
Sponsor: Ascentage Pharma Group Inc. (Pharmaceutical company). Phase: Therapeutic confirmatory (Phase III). Countries: Spain (authorised, recruiting), Bulgaria (ended), Czechia (ongoing, recruiting).
Therapeutic area(s): Diseases [C] - Neoplasms [C04]; Diseases [C] - Hemic and Lymphatic Diseases [C15]
Gender: Female, Male. Age: 18-64 years, 65+ years. Enrolment: 29.
Start date (EU): 2025-08-22. Decision date: 2025-02-18. Results received: No. Last updated: 2026-07-28.
Decision dates by country: BG: 2025-02-21, CZ: 2025-03-26, ES: 2025-02-18

Condition(s): Newly Diagnosed Chronic Lymphocytic Leukemia/Small Lymphocytic Lymphoma
Product: RITUXIMAB, CHLORAMBUCIL, Lisaftoclax, CYCLOPHOSPHAMIDE MONOHYDRATE, Lisaftoclax, RITUXIMAB, Lisaftoclax, ACALABRUTINIB, FLUDARABINE PHOSPHATE

Primary endpoint: IRC-assessed PFS: The time from randomization to PD or death from any cause, whichever occurs first.
Endpoint(s): Key secondary endpoint: Investigator-assessed PFS: The time from randomization to PD or death from any cause, whichever occurs first., Other secondary endpoints: OS: The time from randomization to death., IRC- and investigator-assessed ORR: ORR includes complete response (CR), complete response with incomplete bone marrow recovery (CRi) or partial response (PR). CLL responsewill be assessed according to IWCLL NCI-WG guidelines (2018 Edition), and SLL response will be assessed according to Lugano 2014 criteria for response assessment in lymphoma., IRC- and investigator-assessed TTR: The interval from randomization to the date of the first confirmed CR, CRi, or PR., IRC- and investigator-assessed DOR: The interval from the date of first confirmed CR, CRi or PR to PD, or the start of a new anti-tumor treatment, or death, whichever occurs first., MRD negativity rate: Proportion of patients with MRD-negative result in bone marrow, peripheral blood, either or both., Safety and tolerability of patients: Treatment emergent adverse events (TEAEs) and treatment related adverse events (TRAEs) will be evaluated., Concentration data of Lisaftoclax and critical parameters of population pharmacokinetics.

Source: https://euclinicaltrials.eu/ctis-public/view/2024-514084-26-00